EU clinical trial 2024-516438-36-00: A phase II, open-label, single arm study to evaluate the efficacy of Luspatercept in Erythropoiesis-stimulating agent naive lower-risk MDS patients with or without ring sideroblasts who do not require RBC transfusions (LENNON)
Protocol code: LENNON
Sponsor: Universitaet Leipzig (Educational Institution). Phase: Therapeutic exploratory (Phase II). Countries: Germany (ongoing, recruitment ended).
Therapeutic area(s): Diseases [C] - Immune System Diseases [C20]
Gender: Female, Male. Age: 18-64 years, 65+ years. Enrolment: 30.
Status: Ongoing, recruitment ended. Start date (EU): 2022-09-13. Decision date: 2024-08-16. Results received: No. Last updated: 2026-07-09.

Condition(s): Patients with very low, low or intermediate risk myelodysplastic syndromes (MDS) presenting with anemia, transfusion independence (NTD) and naive towards ESA treatment
Product: Reblozyl 25 mg powder for solution for injection, Reblozyl 75 mg powder for solution for injection

Primary endpoint: The primary efficacy endpoint is erythroid response (HI-E) according to IWG 2018 criteria and defined as an increase in hemoglobin levels by at least 1.5 g/dL, persistent for at least 8 weeks over the baseline hemoglobin level (mean over 16 weeks prior to inclusion) and will be determined after 24 weeks of LUS treatment.
Endpoint(s): To evaluate HI-E response duration on a time horizon of 18 months after response

Source: https://euclinicaltrials.eu/ctis-public/view/2024-516438-36-00